EU clinical trial 2024-512792-13-00: Evaluation of the CHF 5993 concentration in blood, after inhalation with two different devices, (NEXThaler® versus pMDI), with and without Aerochamber spacer device, in healthy volunteers.
Protocol code: CLI-05993BB1-01
Sponsor: Chiesi Farmaceutici S.p.A. (Pharmaceutical company). Phase: Human Pharmacology (Phase I)- Other. Countries: Belgium (ended).
Therapeutic area(s): Diseases [C] - Respiratory Tract Diseases [C08]
Gender: Female, Male. Age: 18-64 years. Enrolment: 66.
Status: Ended. Start date (EU): 2024-11-13. End date (EU): 2025-02-17. Decision date: 2024-10-07. Results received: No. Last updated: 2024-10-21.
Decision dates by country: BE: 2024-10-21

Condition(s): Asthma

Source: https://euclinicaltrials.eu/ctis-public/view/2024-512792-13-00